EU clinical trial 2022-501179-23-00: Dupilumab step-down strategy to maintain remission in adult and adolescents patients with atopic dermatitis: a non-inferiority randomized trial
Protocol code: RC22_0378
Sponsor: Centre Hospitalier Universitaire De Nantes (Hospital/Clinic/Other health care facility). Phase: Therapeutic use (Phase IV). Countries: France (ongoing, recruitment ended).
Therapeutic area(s): Diseases [C] - Skin and Connective Tissue Diseases [C17]
Gender: Female, Male. Age: 0-17 years, 18-64 years, 65+ years. Enrolment: 256.
Status: Ongoing, recruitment ended. Start date (EU): 2023-03-08. Decision date: 2023-02-06. Results received: No. Last updated: 2025-07-11.

Condition(s): atopic dermatitis
Product: DERMAFUSONE 20 mg/1 mg/g, crème, Dupixent 200 mg solution for injection in pre-filled syringe, Dupixent 300 mg solution for injection in pre-filled syringe, Dupixent 300 mg solution for injection in pre-filled pen, Dupixent 200 mg solution for injection in pre-filled pen, CLOBETASOL, DESONIDE

Primary endpoint: Area under the curve of Atopic Dermatitis Control Tool (ADCT) score achieved every week during one year.
Endpoint(s): Mean difference in EASI score from baseline to M4, M8, M12, Mean difference in Investigator global assessment from baseline to M4, M8, M12, Mean difference in Itch numerical rating scale from baseline to M4, M8, M12, Incremental cost-utility ratio (cost per Quality-Adjusted Life-Years, QALYs) from a collective perspective and with a 1-year time horizon, Mean difference in DLQI (CDLQI for children <16) from baseline to M4, M8, M12

Source: https://euclinicaltrials.eu/ctis-public/view/2022-501179-23-00